EU clinical trial 2024-517605-91-00: A Phase 1 open-label positron emission tomography TRIAL to assess changes in liver uptake of [68Ga]Ga-FAPI-46 following oral administration of single doses of AZD2389 to patients with advanced liver fibrosis (PECHORA)
Protocol code: D7930C00003
Sponsor: AstraZeneca AB (Pharmaceutical company). Phase: Human Pharmacology (Phase I)- Other. Countries: Sweden (ended).
Therapeutic area(s): Diseases [C] - Digestive System Diseases [C06]
Gender: Female, Male. Age: 18-64 years, 65+ years. Enrolment: 12.
Status: Ended. Start date (EU): 2025-05-26. End date (EU): 2026-07-02. Decision date: 2025-02-12. Results received: No. Last updated: 2026-06-17.

Condition(s): advanced liver fibrosis

Source: https://euclinicaltrials.eu/ctis-public/view/2024-517605-91-00